EU clinical trial 2024-512227-36-00: A Multicenter, Open-Label, Phase I/II Study of EOS884448 in combination with standard of care and/or investigational therapies in participants with advanced solid tumors
Protocol code: TIG-006
Sponsor: iTeos Belgium (Pharmaceutical company). Phase: Phase I and Phase II (Integrated)- Other. Countries: Italy (ended), France (ended), Belgium (ended), Spain (ended).
Therapeutic area(s): Diseases [C] - Neoplasms [C04]
Gender: Female, Male. Age: 18-64 years, 65+ years. Enrolment: 206.
Status: Ended. Start date (EU): 2021-07-28. End date (EU): 2025-05-15. End date: 2025-05-16. Decision date: 2024-11-13. Results received: Yes. Last updated: 2025-05-06.
Decision dates by country: BE: 2024-11-20, ES: 2024-11-13, IT: 2024-11-25, FR: 2024-11-14

Condition(s): Advanced solid tumors
Product: JEMPERLI 500 mg concentrate for solution for infusion, Inupadenant, Inupadenant HCl, Inupadenant, Inupadenant, KEYTRUDA 25 mg/mL concentrate for solution for infusion, Inupadenant HCl

Primary endpoint: Part 1 – Dose Finding: Incidence and frequency of adverse events (AEs), serious adverse events (SAEs), dose-limiting toxicities (DLTs), AEs leading to discontinuation, deaths, vital signs, electrocardiogram (ECG) abnormalities, LVEF, and clinically significant laboratory abnormalities., Part 2 – Expansion: Overall Response Rate (ORR) will be defined according to RECIST v1.1., Part 2 – Expansion: Incidence and frequency of AEs, SAEs, DLTs, AEs leading to discontinuation, deaths, vital signs, ECG abnormalities, LVEF, and clinically significant laboratory abnormalities.
Endpoint(s): Part 1 – Dose Finding: Overall Response Rate (ORR) will be defined according to RECIST v1.1., Part 1 and Part 2: Duration of Response (DOR), Disease Control Rate (DCR defined as the proportion of participants with a best response of partial response [PR], complete response [CR] or prolonged stable disease [SD]), progression-free-survival (PFS, time from starting treatment until disease progression or death for any reason) will be defined according to RECIST v1.1., Part 1 and Part 2: Summary measures of PK parameters of EOS-448 and incidence of anti-drug antibodies (ADA) to EOS-448., Part 1 and Part 2: Summary measures of PK parameters of inupadenant., Part 1 and Part 2: Summary measures of PK parameters of dostarlimab and incidence of anti-drug antibodies (ADA) to dostarlimab.

Source: https://euclinicaltrials.eu/ctis-public/view/2024-512227-36-00